EU clinical trial 2022-500879-31-00: Individualization of dosage regimens in obese patients: application to acyclovir
Protocol code: RC31/21/0610
Sponsor: Centre Hospitalier Universitaire De Toulouse (Hospital/Clinic/Other health care facility). Phase: Human Pharmacology (Phase I)- Other. Countries: France (ended).
Therapeutic area(s): Diseases [C] - Virus Diseases [C02]
Gender: Female, Male. Age: 18-64 years. Enrolment: 20.
Status: Ended. Start date (EU): 2024-04-09. End date (EU): 2026-07-10. Decision date: 2022-08-12. Results received: No. Last updated: 2024-03-13.

Condition(s): obesity

Source: https://euclinicaltrials.eu/ctis-public/view/2022-500879-31-00